EU clinical trial 2024-520126-11-00: A study to Learn If Study Medicines Called Cyclosporine and Clarithromycin Affect How the Body Processes the Other Study Medicine Called PF-07328948 in Healthy Adults.
Protocol code: C4921008
Sponsor: Pfizer Inc. (Pharmaceutical company). Phase: Human Pharmacology (Phase I)- Other. Countries: Belgium (ended).
Therapeutic area(s): Diseases [C] - Musculoskeletal Diseases [C05]
Gender: Female, Male. Age: 18-64 years, 65+ years. Enrolment: 8.
Status: Ended. Start date (EU): 2025-03-14. End date (EU): 2025-06-11. End date: 2025-06-12. Decision date: 2025-03-13. Results received: No. Last updated: 2025-05-20.

Condition(s): Heart Failure

Source: https://euclinicaltrials.eu/ctis-public/view/2024-520126-11-00